EU clinical trial 2024-510649-33-00: A Phase 1/2, Safety Confirmation, Placebo-controlled, Randomized Study of Nivolumab in Combination with Relatlimab and Bevacizumab in Treatment-naive Advanced/Metastatic Hepatocellular Carcinoma (RELATIVITY-106)
Protocol code: CA224-106
Sponsor: Bristol Myers Squibb International Corporation (Pharmaceutical company). Phase: Phase I and Phase II (Integrated)- Other. Countries: Germany (ended), Spain (ended), France (ended), Italy (ended), Poland (ended).
Therapeutic area(s): Diseases [C] - Neoplasms [C04]
Gender: Female, Male. Age: 18-64 years, 65+ years. Enrolment: 53.
Status: Ended. Start date (EU): 2022-09-02. End date (EU): 2025-10-31. End date: 2025-11-18. Decision date: 2024-04-24. Results received: Yes. Last updated: 2025-10-24.
Decision dates by country: IT: 2024-04-29, PL: 2024-04-29, FR: 2024-04-29, ES: 2024-04-26, DE: 2024-04-24

Condition(s): Advanced/metastatic hepatocellular carcinoma (HCC)
Product: OPDIVO 10 mg/mL concentrate for solution for infusion., Relatlimab intravenous, 0.9% Sodium Chloride Injection, Avastin 25 mg/ml concentrate for solution for infusion.

Primary endpoint: Part 1: Will be assessed by analyzing the rate of dose-limiting toxicities (unwanted side effects) among patients treated at various dose levels; once safety is confirmed, Part 2 will begin., Part 2: Efficacy will be evaluated by comparing the objective response rate (proportion of participants who respond to treatment) of each treatment, in participants with metastatic disease as well as in participants whose disease is limited to their liver.
Endpoint(s): Additional efficacy endpoints will be tested in both groups of participants, including evaluating progression-free survival (time from start of treatment until worsening of disease)., Safety will be evaluated in both groups of participants, specifically reviewing adverse events (unwanted side effects), serious adverse events, and immune-mediated adverse events (unwanted side-effects caused by an overactive immune system) from first dose to 30 or 135 days after the last dose.

Source: https://euclinicaltrials.eu/ctis-public/view/2024-510649-33-00